EU clinical trial 2024-512060-58-00: A study to learn about the safety of BAY 3283142 in people with mild to moderate high blood pressure
Protocol code: 22723
Sponsor: Bayer AG (Pharmaceutical company). Phase: Human Pharmacology (Phase I)- Other. Countries: Germany (ended).
Therapeutic area(s): Diseases [C] - Cardiovascular Diseases [C14]
Gender: Female, Male. Age: 18-64 years, 65+ years. Enrolment: 72.
Status: Ended. Start date (EU): 2024-08-07. End date (EU): 2025-11-21. Decision date: 2024-07-30. Results received: No. Last updated: 2025-10-17.

Condition(s): Chronic kidney disease

Source: https://euclinicaltrials.eu/ctis-public/view/2024-512060-58-00